EU clinical trial 2023-508447-52-00: A study to learn about the taste of Vericiguat given in liquid form in healthy male participants aged 18 to 45 years
Protocol code: 22342
Sponsor: Bayer AG (Pharmaceutical company). Phase: Human Pharmacology (Phase I)- Other. Countries: Germany (ended).
Therapeutic area(s): Diseases [C] - Cardiovascular Diseases [C14]
Gender: Male. Age: 18-64 years. Enrolment: 20.
Status: Ended. Start date (EU): 2024-06-28. End date (EU): 2024-09-30. Decision date: 2024-06-04. Results received: No. Last updated: 2024-06-04.

Condition(s): Heart failure in children

Source: https://euclinicaltrials.eu/ctis-public/view/2023-508447-52-00